EU clinical trial 2023-506680-34-00: A Phase 3, Single-Arm, Multicenter Study to Evaluate the Efficacy and Safety of UGN-102 as Primary Chemoablative Therapy in Patients with Low Grade (LG) Non-Muscle-Invasive Bladder Cancer (NMIBC) at Intermediate Risk (IR) of Recurrence.
Protocol code: BL011
Sponsor: Urogen Pharma Ltd. (Pharmaceutical company). Phase: Therapeutic confirmatory (Phase III). Countries: Latvia (ongoing, recruitment ended), Bulgaria (ongoing, recruitment ended), Austria (ongoing, recruitment ended), Lithuania (ongoing, recruitment ended), Poland (ongoing, recruitment ended), Spain (ongoing, recruitment ended), Estonia (ongoing, recruitment ended).
Therapeutic area(s): Diseases [C] - Neoplasms [C04]
Gender: Female, Male. Age: 18-64 years, 65+ years. Enrolment: 161.
Status: Ongoing, recruitment ended. Start date (EU): 2022-03-24. Decision date: 2024-12-09. Results received: No. Last updated: 2026-05-08.
Decision dates by country: AT: 2024-12-11, EE: 2024-12-11, LV: 2024-12-09, LT: 2024-12-10, BG: 2024-12-09, ES: 2024-12-10, PL: 2024-12-09

Condition(s): Non-Muscle Invasive Bladder Cancer
Product: UGN-102 (Mitomycin)

Primary endpoint: CRR, defined as the proportion of patients who achieved CR at the 3 month Visit (3 months after the first instillation of UGN-102) as determined by cystoscopy, for cause biopsy, and urine cytology.
Endpoint(s): 1. DOR in patients who achieved CR at the 3 month Visit, defined as the time from the date of evidence of CR at the 3 month Visit to the earliest date of recurrence or progression as determined using the date of cystoscopy, for cause biopsy, or cytology, or death due to any cause, whichever occurred first., 2. DCR rate at scheduled disease assessment time points, defined as the proportion of patients who achieved CR at the 3-month Visit and maintained CR (ie, no detectable disease) up to that particular follow up disease assessment., 3. DFS in patients who achieved CR at the 3 month Visit, defined as the time from first dose to the earliest date of recurrence or progression as determined using the date of cystoscopy, for cause biopsy, or cytology, or death due to any cause, whichever occurred first., 4. The safety profile of UGN-102 will be evaluated through the reporting of AEs, including SAEs and AESIs, and through standard clinical and laboratory tests (eg, hematology and chemistry, urinalysis, physical examination, and vital signs)., Exploratory 1. TTR in patients who were NCR (residual disease) at the 3-month Visit, defined as the time from the date of first treatment after NCR to the earliest date of recurrence or progression as determined using the date of cystoscopy, for cause biopsy, or cytology, whichever occurred first., Exploratory 2. Number (%) of response outcomes evaluated at the first disease assessment visit after SOC., Exploratory 3. Proportion of patients whose planned NMIBC treatment at baseline was downgraded following treatment with UGN-102 (eg, from TURBT to biopsy and/or fulguration)., Exploratory 4. Changes from baseline in patient scores on the QLQ C30 and QLQ-NMIBC24 questionnaires.

Source: https://euclinicaltrials.eu/ctis-public/view/2023-506680-34-00